EU clinical trial 2022-502645-99-00: A Phase 1/2, Multi-Center, Open-Label Study to Evaluate the Safety, Tolerability, and Preliminary Anti-tumor Activity of TNG462 as a Single Agent and in Combination in Patients with MTAP-deleted Advanced or Metastatic Solid Tumors
Protocol code: TNG462-C101
Sponsor: Tango Therapeutics Inc. (Pharmaceutical company). Phase: Phase I and Phase II (Integrated)- First administration to humans. Countries: Spain (ongoing, recruitment ended), France (ongoing, recruitment ended).
Therapeutic area(s): Diseases [C] - Neoplasms [C04]
Gender: Female, Male. Age: 18-64 years, 65+ years. Enrolment: 70.
Status: Ongoing, recruitment ended. Start date (EU): 2023-08-09. Decision date: 2023-06-26. Results received: No. Last updated: 2026-03-04.
Decision dates by country: FR: 2023-07-06, ES: 2023-06-26

Condition(s): MTAP-deleted Advanced or Metastatic Solid Tumors
Product: BUCCOLAM 10 mg oromucosal solution, BUCCOLAM 5 mg oromucosal solution, TNG462, TNG462, BUCCOLAM 2.5 mg oromucosal solution, PEMBROLIZUMAB, BUCCOLAM 7.5 mg oromucosal solution, TNG462, TNG462, TNG462

Primary endpoint: Phase 1: • Incidence of DLTs within the first 28 days of treatment with TNG462 as a single agent • Incidence of DLTs within the first 21 days of treatment with TNG462 plus pembrolizumab Phase 2: • ORR (CR + PR) as determined by RECIST v1.1, mRECIST v1.1, or iRECIST per investigator assessment • DOR as determined by RECIST v1.1, mRECIST v1.1 or iRECIST per investigator assessment • PFS by investigator assessment • CBR (CR + PR + stable disease) at 16 weeks
Endpoint(s): Phase 1: • ORR (CR + PR) as determined by RECIST v1.1, mRECIST v1.1 or iRECIST, per investigator assessment • DOR as determined by RECIST v1.1, mRECIST v1.1 or iRECIST,per investigator assessment • PFS by investigator assessment • CBR (CR + PR + stable disease) at 16 weeks for patients treated with single agent or at 18 weeks for patients treated with the pembrolizumab combination, Phase 1 and 2: Type, frequency, severity, timing, and relationship to study treatment of any AEs, SAEs, and changes in vital signs, ECGs, and safety laboratory tests PK parameters of TNG462 Pre-treatment and trough pembrolizumab concentrations Changes in SDMA levels in tumor after dosing with TNG462

Source: https://euclinicaltrials.eu/ctis-public/view/2022-502645-99-00